EU clinical trial 2023-509354-58-00: A Phase 3, Randomized, Double-blind, Placebo-controlled, Multicenter Study of Bendamustine and Rituximab (BR) Alone Versus in Combination with Acalabrutinib (ACP-196) in Subjects with Previously Untreated Mantle Cell Lymphoma
Protocol code: ACE-LY-308
Sponsor: Acerta Pharma B.V. (Pharmaceutical company). Phase: Therapeutic confirmatory (Phase III). Countries: Belgium (ended), Germany (ongoing, recruitment ended), Czechia (ongoing, recruitment ended), Spain (ongoing, recruitment ended), Hungary (ongoing, recruitment ended), France (ongoing, recruitment ended), Italy (ongoing, recruitment ended), Poland (ongoing, recruitment ended), Greece (ongoing, recruitment ended).
Therapeutic area(s): Diseases [C] - Neoplasms [C04]
Gender: Female, Male. Age: 65+ years. Enrolment: 198.
Start date (EU): 2017-07-14. Decision date: 2024-05-31. Results received: No. Last updated: 2026-04-08.
Decision dates by country: IT: 2024-06-05, BE: 2024-06-03, CZ: 2024-06-04, DE: 2024-06-04, ES: 2024-05-31, HU: 2024-06-04, GR: 2024-08-19, FR: 2024-05-31, PL: 2024-07-10

Condition(s): Mantle Cell Lymphoma
Product: RITUXIMAB, Capsule, hard, Calquence 100 mg hard capsules, BENDAMUSTINE

Primary endpoint: The primary endpoint of the study is PFS as assessed by IRC per the Lugano Classification for NHL. The primary analysis is a comparison of PFS between Arm 1 (acalabrutinib plus BR) and Arm 2 (placebo plus BR).
Endpoint(s): Investigator-assessed PFS per the Lugano Classification for NHL, Investigator-assessed ORR (CR+PR) per the Lugano Classification for NHL, IRC-assessed ORR (CR+PR) per the Lugano Classification for NHL, OS, IRC-assessed DOR per the Lugano Classification for NHL, IRC assessed TTR per the Lugano Classification for NHL, PK characteristics of acalabrutinib and its active metabolite (ACP-5862), alone and when given in combination with bendamustine

Source: https://euclinicaltrials.eu/ctis-public/view/2023-509354-58-00